EU clinical trial 2024-517569-18-00: FIRST IN HUMAN PHASE 1 DOSE ESCALATION AND EXPANSION CLINICAL TRIAL TO EVALUATE THE SAFETY, PHARMACOKINETICS AND ANTITUMOR ACTIVITY OF INTRAVENOUS AROG4-01 IN PATIENTS WITH ADVANCED SOLID TUMORS.
Protocol code: AROG4-01-01
Sponsor: Applied Research Using Omic Sciences S.L. (Pharmaceutical company). Phase: Human Pharmacology (Phase I)- First administration to humans. Countries: Spain (authorised, recruitment pending).
Therapeutic area(s): Diseases [C] - Neoplasms [C04]
Gender: Female, Male. Age: 18-64 years, 65+ years. Enrolment: 40.
Status: Authorised, recruitment pending. Decision date: 2025-04-11. Results received: No. Last updated: 2025-05-06.

Condition(s): Patients with advanced refractory solid tumors.

Source: https://euclinicaltrials.eu/ctis-public/view/2024-517569-18-00